EU clinical trial 2024-514539-67-00: A Randomized, Double-Blinded, Placebo-Controlled, Phase 2, Parallel-Group Study to Evaluate the Efficacy, Safety, Tolerability, Pharmacodynamics, Pharmacokinetics, and Immunogenicity of Efgartigimod PH20 SC in Adult Participants With Systemic Sclerosis
Protocol code: ARGX-113-2317
Sponsor: Argenx (Pharmaceutical company). Phase: Therapeutic exploratory (Phase II). Countries: Lithuania (ongoing, recruiting), Bulgaria (ongoing, recruiting), Croatia (ongoing, recruiting), France (ongoing, recruiting), Portugal (ongoing, recruiting), Hungary (authorised, recruiting), Netherlands (ongoing, recruiting), Czechia (ongoing, recruiting), Germany (ongoing, recruiting), Poland (ongoing, recruiting), Romania (ongoing, recruiting), Denmark (authorised, recruiting), Belgium (ongoing, recruiting), Italy (ongoing, recruiting), Spain (ongoing, recruiting), Greece (ongoing, recruiting).
Therapeutic area(s): Diseases [C] - Immune System Diseases [C20]; Diseases [C] - Skin and Connective Tissue Diseases [C17]
Gender: Female, Male. Age: 18-64 years, 65+ years. Enrolment: 119.
Start date (EU): 2025-06-27. Decision date: 2025-04-15. Results received: No. Last updated: 2026-05-29.
Decision dates by country: BE: 2025-04-15, BG: 2025-04-17, HR: 2025-04-22, CZ: 2025-04-15, DK: 2025-04-15, FR: 2025-04-16, DE: 2025-04-15, GR: 2025-04-15, HU: 2025-04-16, IT: 2025-04-16, LT: 2025-04-16, NL: 2025-04-22, PL: 2025-04-22, RO: 2025-04-22, ES: 2025-04-15, PT: 2025-04-15

Condition(s): Systemic Sclerosis
Product: placebo PH20 SC PFS, Vyvgart 1 000 mg solution for injection in pre-filled syringe

Primary endpoint: Change from baseline in modified Rodnan Skin Score (mRSS) at week 24
Endpoint(s): 1. Change from baseline in mRSS at week 48, 2. Incidence and severity of treatment-emergent adverse events (AEs), serious AEs (SAEs), and AEs leading to discontinuation of investigational medicinal product (IMP), 3. Clinically meaningful changes in laboratory parameters, electrocardiograms (ECGs), and vital signs, 4. Proportion of participants who improve in ≥2 or ≥3 of the 5 core items of CRISS-25 at weeks 24 and 48 and do not have worsening in >1 component and have no significant SSc-related event(s), 5. Change from baseline in Health Assessment Questionnaire—Disability Index (HAQ-DI) at weeks 24 and 48, 6. Change from baseline in Patient Global Assessment (PGA) at weeks 24 and 48, 7. Change from baseline in Clinician’s Global Assessment (CGA) at weeks 24 and 48, 8. Annualized rate of decline in forced vital capacity (FVC; in mL) in participants with interstitial lung disease (ILD), 9. Efgartigimod serum concentrations over time, 10. Percent change from baseline in total IgG levels in serum over time, 11. Incidence and prevalence of antidrug antibodies (ADA) against efgartigimod in serum over time, 12. Incidence and prevalence of antibodies against recombinant human hyaluronidase PH20 (rHuPH20) in plasma over time

Source: https://euclinicaltrials.eu/ctis-public/view/2024-514539-67-00